EU clinical trial 2023-504721-39-02: A Phase II, Multicenter, Open-label Study to Evaluate the Efficacy and Safety of Trastuzumab Deruxtecan (T-DXd, DS-8201a) for the Treatment of Selected HER2-expressing Tumors (DESTINY-PanTumor02)
Protocol code: D967VC00001
Sponsor: AstraZeneca AB (Pharmaceutical company). Phase: Therapeutic exploratory (Phase II). Countries: Poland (ongoing, recruitment ended), Spain (ongoing, recruitment ended), Italy (ongoing, recruitment ended).
Therapeutic area(s): Diseases [C] - Neoplasms [C04]
Gender: Female, Male. Age: 18-64 years, 65+ years. Enrolment: 110.
Status: Ongoing, recruitment ended. Start date (EU): 2020-12-07. Decision date: 2024-07-26. Results received: No. Last updated: 2026-02-17.
Decision dates by country: IT: 2024-08-05, PL: 2024-08-29, ES: 2024-07-26

Condition(s): HER2 Expressing Tumors
Product: DS-8201a

Primary endpoint: Objective Response Rate (ORR) according to RECIST v1.1, as assessed by investigator
Endpoint(s): Based on RECIST 1.1, as assessed by Investigator: 1) Duration of response (DoR)., Disease control rate (DCR)., Progression free survival (PFS)., Proportion of patients alive and progression-free at 3 monthly intervals staring from 6 months., Overall survival (OS)., Proportion of patients alive at 3 monthly intervals staring from 6 months, Occurrence of adverse events (AEs) and serious adverse events (SAEs)., Pharmacokinetics (PK) assessed by serum concentration of T-DXd, total anti-HER2 antibody and MAAA-1181., The immunogenicity of T-DXd assessed by the presence of ADAs for T-DXd.

Source: https://euclinicaltrials.eu/ctis-public/view/2023-504721-39-02